EU clinical trial 2022-502801-13-00: A Phase 2, Prospective, Interventional, Open-Label, Multisite, Extension Study to Assess the Long-Term Safety and Tolerability of Soticlestat (TAK-935) as Adjunctive Therapy in Subjects with Developmental Epileptic Encephalopathies Including Dravet Syndrome, Lennox Gastaut Syndrome, CDKL5 Deficiency Disorder, and Chromosome 15 Duplication Syndrome (ENDYMION 1)
Protocol code: TAK-935-18-001
Sponsor: Takeda Development Center Americas Inc. (Pharmaceutical company). Phase: Therapeutic exploratory (Phase II). Countries: Spain (ended), Portugal (ended), Poland (ended).
Therapeutic area(s): Diseases [C] - Nervous System Diseases [C10]
Gender: Female, Male. Age: 0-17 years, 18-64 years. Enrolment: 51.
Status: Ended. Start date (EU): 2019-07-26. End date (EU): 2025-03-25. End date: 2025-07-30. Decision date: 2023-08-23. Results received: Yes. Last updated: 2025-05-13.
Decision dates by country: ES: 2023-08-23, PT: 2023-08-23, PL: 2023-09-27

Condition(s): Epileptic Encephalopathies: Dravet Syndrome, Lennox Gastaut Syndrome, CDKL5 Deficiency Disorder, and Chromosome 15 Duplication Syndrome, other adult DEEs.

Primary endpoint: Incidence of AEs., Change from Baseline in behavioral and adaptive functional measures using the Vineland Adaptive Behavior Scale (VABS)., Change from Baseline in behavior measures using total scores and subscale scores of the Aberrant Behavior Checklist-Community Edition (ABC-C) for subjects ≥6 years of age., Change from Baseline in the Columbia-Suicide Severity Rating Scale (CSSRS) categorization based on Columbia Classification Algorithm of Suicide Assessment categories 1, 2, 3, 4, and 5 for subjects ≥6 years of age., Absolute values and change from Baseline in clinical laboratory assessments, vital sign measurements, body weight, and electrocardiogram (ECG) parameters., Incidence of potentially clinically significant clinical safety laboratory test values, vital signs, weight, height, and ECG evaluations.
Endpoint(s): Percent change from Baseline in all seizure 28-day frequency., Percent change from Baseline in drop seizure 28-day frequency (LGS subjects)., Percent change from Baseline in convulsive seizure 28-day frequency (DS subjects)., Percent change from Baseline in motor seizure 28-day frequency, Change from Baseline in CGI-S.

Source: https://euclinicaltrials.eu/ctis-public/view/2022-502801-13-00